EU clinical trial 2024-514405-65-00: A Multicenter, Open-Label, Single-Group Clinical Trial to Assess the Pharmacokinetics, Safety and Efficacy of Nemolizumab (CD14152) in Pediatric Subjects (aged 2 to 11 years) with Moderate-to-Severe Atopic Dermatitis
Protocol code: RD.06.SPR.118126
Sponsor: Galderma S.A. (Pharmaceutical company). Phase: Therapeutic exploratory (Phase II). Countries: Hungary (ended), Spain (ended), Poland (ended).
Therapeutic area(s): Diseases [C] - Skin and Connective Tissue Diseases [C17]
Gender: Female, Male. Age: 0-17 years. Enrolment: 100.
Status: Ended. Start date (EU): 2021-11-22. End date (EU): 2025-04-28. Decision date: 2024-10-15. Results received: Yes. Last updated: 2024-12-17.
Decision dates by country: PL: 2024-10-21, ES: 2024-10-17, HU: 2024-10-15

Condition(s): Atopic Dermatitis
Product: Nemolizumab

Primary endpoint: • Nemolizumab serum concentrations at Weeks 4, 8, 12, 16, 32, and 52. • Nemolizumab serum PK parameters estimated with a population PK analysis., • Incidence of adverse events (AEs), including treatment-emergent AEs (TEAEs), AEs of special interests (AESIs), AEs leading to discontinuation and serious AEs (SAEs) through the study.
Endpoint(s): • Absolute and percent change in EASI score from baseline at each visit up to Week 16 and up to Week 52 • Proportion of subjects achieving 50%, 75% or 90% response in EASI [EASI-50, EASI-75, and EASI-90] at baseline and at each visit up to Week 16 and Week 52 • IGA success rate (defined as an IGA of 0 [Clear] or 1 [Almost clear] and a ≥2-point improvement from baseline) at each visit up to Week 16 and up to Week 52

Source: https://euclinicaltrials.eu/ctis-public/view/2024-514405-65-00